EU clinical trial 2023-503730-45-00: Folinic acid therapy in patients with Kearns-Sayre syndrome (KSS) and cerebral folate deficiency - mitoFolat
Protocol code: 2.0
Sponsor: Universitaetsmedizin Goettingen (Hospital/Clinic/Other health care facility). Phase: Therapeutic exploratory (Phase II). Countries: Germany (ongoing, recruiting).
Therapeutic area(s): Diseases [C] - Nervous System Diseases [C10]
Gender: Female, Male. Age: 0-17 years. Enrolment: 18.
Status: Ongoing, recruiting. Start date (EU): 2025-03-21. Decision date: 2023-10-25. Results received: No. Last updated: 2025-11-03.

Condition(s): Kearns-Sayre-Syndrom
Product: CALCIUM FOLINATE

Primary endpoint: International Pediatric Mitochondrial Disease Scale (IPMDS) will be measured at 7 time points (baseline, months 3, 6, 9, 12, 15, and 18). Primary endpoint is the baseline adjusted mean difference between experimental treatment and no-treatment control group after 6 months. Changes between baseline value and the measurements after treatment start at month 6, 12, 18, respectively will also be analysed
Endpoint(s): Biomarker (5-methyltetrahydrofolate, 5MTHF) concentration in CSF, Regional brain volume, size and extension of white matter alterations and myelination assessed by magnetic resonance imaging (MRI), Concentrations of choline, myo-inositol assessed by 1H magnetic resonance spectroscopy (MRS), Baseline adjusted mean differences between Newcastle Paediatric Mitochondrial Disease Scale (NPMDS)

Source: https://euclinicaltrials.eu/ctis-public/view/2023-503730-45-00